EU clinical trial 2022-502942-29-01: A Phase 1/2 Ascending Dose Study to Evaluate the Safety and Effects on Progranulin Levels of LY3884963 in Patients with Fronto-Temporal Dementia with Progranulin Mutations (FTD-GRN) (PROCLAIM)
Protocol code: J4B-MC-OKAA
Sponsor: Prevail Therapeutics Inc. (Pharmaceutical company). Phase: Phase I and Phase II (Integrated)- Other. Countries: France (ended), Belgium (ongoing, recruitment ended).
Therapeutic area(s): Diseases [C] - Nervous System Diseases [C10]
Gender: Female, Male. Age: 18-64 years, 65+ years. Enrolment: 13.
Start date (EU): 2026-03-23. Decision date: 2024-08-05. Results received: No. Last updated: 2026-05-12.
Decision dates by country: FR: 2024-08-13, BE: 2024-08-05

Condition(s): Fronto-Temporal Dementia with Progranulin Mutations (FTD-GRN)
Product: Rapamune 0.5 mg coated tablets, Rapamune 0.5 mg coated tablets, PREDNISONA CINFA 10 MG COMPRIMIDOS, Rapamune 1 mg coated tablets, Rapamune 0.5 mg coated tablets, Rapamune 1 mg coated tablets, Rapamune 1 mg coated tablets, Prednisone Mylan Pharma 5 mg compresse, Rapamune 0.5 mg coated tablets, Rapamune 1 mg coated tablets, Rapamune 0.5 mg coated tablets, Rapamune 1 mg coated tablets, Rapamune 1 mg coated tablets, Rapamune 0.5 mg coated tablets, Rapamune 1 mg coated tablets, SIROLIMUS, Rapamune 1 mg coated tablets, Rapamune 0.5 mg coated tablets, Solu-Medrol 1000 mg por és oldószer oldatos injekcióhoz, Rapamune 0.5 mg coated tablets

Primary endpoint: The following primary safety endpoints will be measured up to 5 years: • Incidence and severity of treatment-emergent adverse events and serious adverse events (see study protocol for details)., • For patients who received Sirolimus: treatment-emergent hypercholesterolemia or hyperlipidemia; treatment-emergent proteinuria; treatment-emergent interstitial lung disease; and sirolimus trough levels., • For patients who received Rituximab: treatment-emergent hypogammaglobulinemia; and lymphocyte immunophenotyping., • Incidence of procedure or treatment-emergent safety findings per brain and spine MRI., • Change from baseline in immunogenicity of AAV9, PGRN, and NfL in blood and in CSF over time., The following are the primary efficacy endpoints: • Change from baseline in PGRN levels in blood over time. • Change from baseline in PGRN levels in CSF over time.
Endpoint(s): • Change from baseline in CDR plus NACC FTLD over time. • Change from baseline in NfL levels in blood over time. • Change from baseline in NfL levels in CSF over time.

Source: https://euclinicaltrials.eu/ctis-public/view/2022-502942-29-01